EU clinical trial 2023-507117-10-00: A Study to Learn How Different Forms of Study Medicine CTB-AVP Are Taken up Into the Blood and How It Is Taken up Into The Blood When Taken on An Empty Stomach or Taken With a Meal in Healthy Adults
Sponsor: Pfizer Inc. (Pharmaceutical company). Phase: Human Pharmacology (Phase I)- Other. Countries: Belgium (ended).
Therapeutic area(s): Diseases [C] - Bacterial Infections and Mycoses [C01]
Gender: Female, Male. Age: 18-64 years, 65+ years. Enrolment: 12.
Status: Ended. Start date (EU): 2024-07-09. End date (EU): 2024-10-11. End date: 2024-10-12. Decision date: 2023-10-10. Results received: No. Last updated: 2024-07-03.

Condition(s): Complicated urinary tract infection including pyelonephritis

Source: https://euclinicaltrials.eu/ctis-public/view/2023-507117-10-00